EU clinical trial 2023-509216-28-00: EffisayilTM ON: An open-label, long term extension study to assess the safety and efficacy of spesolimab treatment in patients with Generalized Pustular Psoriasis (GPP)
Protocol code: 1368-0025
Sponsor: Leo Pharma A/S (Pharmaceutical company). Phase: Therapeutic exploratory (Phase II). Countries: France (ongoing, recruitment ended), Italy (ongoing, recruitment ended), Germany (ongoing, recruitment ended), Belgium (ongoing, recruitment ended), Spain (ongoing, recruitment ended).
Therapeutic area(s): Diseases [C] - Skin and Connective Tissue Diseases [C17]
Gender: Female, Male. Age: 0-17 years, 18-64 years, 65+ years. Enrolment: 25.
Status: Ongoing, recruitment ended. Start date (EU): 2019-05-27. Decision date: 2024-02-12. Results received: No. Last updated: 2026-08-03.
Decision dates by country: FR: 2024-02-13, DE: 2024-02-13, BE: 2024-02-19, ES: 2024-02-12, IT: 2024-03-18

Condition(s): Generalized Pustular Psoriasis
Product: Spesolimab

Primary endpoint: Occurrence of treatment emergent adverse events (TEAEs) up to week 252 of maintenance treatment
Endpoint(s): The reoccurrence of a GPP flare defined by GPPGA, Time to first achievement of a GPPGA score of 0 or 1 in patients who received flare rescue treatment, A GPPGA pustulation sub-score of 0 indicating no visible pustules, by visit in patients who received flare rescue treatment, Change from baseline in Psoriasis Symptom Scale (PSS) score, by visit in patients who received flare rescue treatment

Source: https://euclinicaltrials.eu/ctis-public/view/2023-509216-28-00